EU clinical trial 2022-501254-10-00: A Multicenter, Open-label, Phase 3 Study to Evaluate the Long-term Safety and Efficacy in Participants who are Currently on Treatment or in Follow-up in Studies That Include Pembrolizumab
Protocol code: MK-3475-587
Sponsor: Merck Sharp & Dohme LLC (Pharmaceutical company). Phase: Therapeutic confirmatory (Phase III). Countries: Spain (ongoing, recruiting), Portugal (ongoing, recruiting), Romania (ongoing, recruiting), Ireland (ongoing, recruiting), Italy (ongoing, recruiting), Netherlands (ongoing, recruiting), Denmark (ongoing, recruiting), Norway (ongoing, recruiting), Czechia (ongoing, recruiting), Lithuania (ongoing, recruiting), Estonia (ended), Poland (ongoing, recruiting), Sweden (ongoing, recruiting), Germany (ongoing, recruiting), Hungary (ongoing, recruiting), Finland (ongoing, recruiting), Belgium (ongoing, recruiting), Latvia (ongoing, recruiting), France (ongoing, recruiting), Austria (ongoing, recruiting), Greece (ongoing, recruiting).
Therapeutic area(s): Diseases [C] - Neoplasms [C04]
Gender: Female, Male. Age: 18-64 years, 65+ years. Enrolment: 1343.
Start date (EU): 2018-08-24. Decision date: 2022-12-14. Results received: No. Last updated: 2026-03-19.
Decision dates by country: FR: 2023-01-13, IT: 2022-12-16, PL: 2022-12-20, RO: 2022-12-15, DE: 2022-12-16, LV: 2022-12-20, GR: 2023-09-13, NL: 2022-12-19, PT: 2022-12-16, CZ: 2022-12-19, BE: 2022-12-16, EE: 2022-12-19, HU: 2022-12-14, AT: 2023-02-03, IE: 2022-12-16, ES: 2022-12-14, LT: 2022-12-15, SE: 2022-12-14, DK: 2022-12-16, FI: 2022-12-16, NO: 2022-12-16

Condition(s): Advanced tumors
Product: Olaparib, favezelimab, Lenvatinib, MK-4280A, Lenvatinib, Olaparib, Lenvatinib, KEYTRUDA 25 mg/mL concentrate for solution for infusion

Primary endpoint: Overall Survival (OS)
Endpoint(s): Modified Progression Free Survival (PFS) Per Evaluation Criteria Used in the Parent Trial, Modified Event Free Survival (EFS) Per Evaluation Criteria Used in the Parent Trial, Number of Participants Who Experience Serious Adverse Events (SAEs), Number of Participants Who Experience Adverse Events of Special Interest (AEOSI), Number of Participants Who Experience Clinically Significant Adverse Events (CSAE), Number of Participants Who Experience Events of Clinical Interest (ECI), Number of Participants Who Discontinue Study Treatment Due to an AE

Source: https://euclinicaltrials.eu/ctis-public/view/2022-501254-10-00